EU clinical trial 2024-512683-53-00: RANDOMIZED CLINICAL TRIAL, OPEN, TO EVALUATE THE BLADDER INSTILLATION OF NEOADYUVANT CHEMOTHERAPY TO THE TRANSURETHAL RESECTION OF BLADDER FOR THE PREVENTION OF RECURRENCE OF NONMUSCLE-INVASIVE UROTHELIAL CARCINOMA
Sponsor: Hospital Universitario La Paz (Hospital/Clinic/Other health care facility). Phase: Therapeutic use (Phase IV). Countries: Spain (authorised, recruiting).
Therapeutic area(s): Diseases [C] - Neoplasms [C04]
Gender: Female, Male. Age: 18-64 years, 65+ years. Enrolment: 312.
Status: Authorised, recruiting. Start date (EU): 2018-05-18. Decision date: 2024-04-23. Results received: No. Last updated: 2024-04-23.

Condition(s): Non-muscle invasive bladder cancer
Product: Cisplatino Pharmacia 1 mg/ml concentrado para solución para perfusión EFG, Farmiblastina 50 mg polvo para solución inyectable, Mitomicina Accord 40 mg polvo para solución inyectable y para perfusión EFG, Gemcitabina Accord 1 g Pó para solução para perfusão, Docetaxel Aurovitas 20 mg/ml concentrado para solución para perfusión, Farmorubicina 50 mg polvo para solución inyectable y para perfusión

Primary endpoint: Early recurrence rate of CVNMI.
Endpoint(s): Adverse events of the drugs administered., Demographic characteristics (age, sex)., Clinical characteristics (TNM classification, risk group, time of evolution, previous treatments received)

Source: https://euclinicaltrials.eu/ctis-public/view/2024-512683-53-00